EU clinical trial 2024-520228-28-00: Phase 2, open-label, single-arm study on the use of metformin as adjunctive therapy in high-grade glioma
Protocol code: GBM-MET
Sponsor: Universita Degli Studi Di Milano Bicocca (Educational Institution). Phase: Therapeutic exploratory (Phase II). Countries: Italy (ongoing, recruiting).
Therapeutic area(s): Diseases [C] - Neoplasms [C04]
Gender: Female, Male. Age: 18-64 years, 65+ years. Enrolment: 25.
Status: Ongoing, recruiting. Start date (EU): 2025-02-10. Decision date: 2025-02-10. Results received: No. Last updated: 2025-11-03.

Condition(s): IDH-wildtype glioblastoma
Product: METFORMIN

Primary endpoint: PFS assessed at V3 (at approximately 6 months after treatment initiation). Progression is defined as recurrence from documentable disease on MRI by assessment with RANO (Response Assessment in Neurooncology) criteria (MRI T1w-Gd; T2 Flair)
Endpoint(s): Health-related quality of life measured by EORTC QLQ-C30 and MMSE questionnaires assessed at V0 and V3. The data obtained will be compared with population data, Safety will be assessed throughout the study as type, frequency and severity of grade III and IV events. Tolerability will be assessed as number of discontinuations or dose reduction and by evaluation of clinical and hematochemical parameters (blood count, liver and kidney toxicity, blood glucose) assessed during the study., Plasma measurement of circulating metabolites, adiponectin and proteomic analysis as potential prognostic and response markers. Overall assessment of this endpoint will be performed at the end of the study., In vitro response of cells taken from patients' tissue samples during surgery to treatment with TMZ or TMZ plus MET or vehicle measured as cell growth inhibition and correlation with clinical response (PFS) of the same patient. - Transcriptomic analysis to identify the molecular phenotype of cells taken from patients' tissue samples during surgery and comparison between clinical response and molecular phenotype. Evaluation of these endpoints will be performed at the end of recruitment.

Source: https://euclinicaltrials.eu/ctis-public/view/2024-520228-28-00